EU clinical trial 2023-505699-31-00: A Phase 3 Multicenter, Long-Term Extension Study to Evaluate the Safety and Efficacy of Upadacitinib (ABT-494) in Subjects with Ulcerative Colitis (UC).
Protocol code: M14-533
Sponsor: AbbVie Deutschland GmbH & Co. KG (Pharmaceutical company). Phase: Therapeutic confirmatory (Phase III). Countries: France (ongoing, recruitment ended), Latvia (ongoing, recruitment ended), Netherlands (ended), Norway (ongoing, recruitment ended), Ireland (ended), Finland (ended), Portugal (ongoing, recruitment ended), Belgium (ongoing, recruitment ended), Estonia (ongoing, recruitment ended), Spain (ongoing, recruitment ended), Germany (ended), Slovakia (ongoing, recruitment ended), Czechia (ongoing, recruitment ended), Hungary (ongoing, recruitment ended), Italy (ongoing, recruitment ended), Austria (ongoing, recruitment ended), Croatia (ongoing, recruitment ended), Poland (ongoing, recruitment ended), Greece (ongoing, recruitment ended), Lithuania (ongoing, recruitment ended).
Therapeutic area(s): Diseases [C] - Digestive System Diseases [C06]
Gender: Female, Male. Age: 0-17 years, 18-64 years, 65+ years. Enrolment: 167.
Start date (EU): 2017-01-02. Decision date: 2023-12-19. Results received: No. Last updated: 2026-05-25.
Decision dates by country: NL: 2023-12-19, FI: 2023-12-19, IE: 2023-12-19, EE: 2024-01-08, PT: 2023-12-20, DE: 2023-12-29, LV: 2023-12-19, FR: 2023-12-19, AT: 2023-12-28, PL: 2024-01-10, NO: 2023-12-19, LT: 2024-02-02, IT: 2023-12-20, HU: 2023-12-20, HR: 2023-12-21, BE: 2023-12-22, ES: 2024-01-04, GR: 2024-03-04, CZ: 2023-12-20, SK: 2023-12-20

Condition(s): Ulcerative Colitis
Product: Upadacitinib, Placebo for upadacitinib tablet, Upadacitinib, Upadacitinib

Primary endpoint: Incidence of adverse events (AEs) will be assessed for the Main Study. Changes from the LTE Baseline over time in vital signs, physical examination and clinical laboratory results will also be assessed.
Endpoint(s): Efficacy endpoint of Main study: Proportion of subjects achieving clinical remission per Adapted Mayo score (defined as SFS ≤ 1 and not greater than baseline, RBS of 0, and end.oscopy subscore ≤ 1) at Week 0, Week 48, and every 48 weeks thereafter.

Source: https://euclinicaltrials.eu/ctis-public/view/2023-505699-31-00